EU clinical trial 2023-508864-31-00: A Phase 3, Open-Label Long-Term Extension Study to Evaluate the Safety and Efficacy of BMN 111 in Children with Achondroplasia
Protocol code: 111-302
Sponsor: Biomarin Pharmaceutical Inc. (Pharmaceutical company). Phase: Therapeutic confirmatory (Phase III). Countries: Spain (ongoing, recruitment ended), Germany (ongoing, recruitment ended).
Therapeutic area(s): Phenomena and Processes [G] - Musculoskeletal and Neural Physiological Phenomena [G11]
Gender: Female, Male. Age: 0-17 years. Enrolment: 22.
Status: Ongoing, recruitment ended. Start date (EU): 2019-04-03. Decision date: 2024-04-30. Results received: No. Last updated: 2026-07-31.
Decision dates by country: DE: 2024-05-02, ES: 2024-04-30

Condition(s): Achondroplasia
Product: Voxzogo 1.2 mg powder and solvent for solution for injection, Voxzogo 0.56 mg powder and solvent for solution for injection, Voxzogo 0.4 mg powder and solvent for solution for injection

Primary endpoint: 1)Key efficacy endpoints: a)Change from baseline in AGV b) Change from baseline in height Z-score c)Change from baseline in upper to lower body segment ratio, 2)Safety assessments: Incidence, severity, and relationship to study drug of all treatment-emergent adverse events (TEAEs)., 3)Procedures/ interventions/ surgeries, imaging assessments, clinical laboratory assessments, Child Behavior Checklist (CBCL), vital signs, electrocardiogram (ECG), and hip clinical assessment.
Endpoint(s): Change from baseline in: 1)Upper Arm Length to Lower Arm (Forearm), Length Ratio, 2)Upper Leg Length (Thigh) to Knee to Heel Length Ratio, 3)Upper Leg Length (Thigh) to Tibial Length Ratio, 4)Arm Span to Standing Height Ratio, 5)Bone age, bone age Z-score, bone mineral density, (BMD), BMD Z-score, and bone mineral content (BMC), 6)QoLISSY and PedsQL domain and total scores

Source: https://euclinicaltrials.eu/ctis-public/view/2023-508864-31-00